EU clinical trial 2024-519356-87-00: Efficacy and safety trial of intraperitoneal furosemide in patients on peritoneal dialysis
Sponsor: Fundacion Para El Fomento De La Investigacion Sanitaria Y Biomedica De La Comunitat Valenciana (Patient organisation/association). Phase: Therapeutic use (Phase IV). Countries: Spain (authorised, recruiting).
Therapeutic area(s): Diseases [C] - Pathological Conditions, Signs and Symptoms [C23]; Diseases [C] - Nutritional and Metabolic Diseases [C18]; Diseases [C] - Cardiovascular Diseases [C14]
Gender: Female, Male. Age: 18-64 years, 65+ years. Enrolment: 37.
Status: Authorised, recruiting. Start date (EU): 2025-06-13. Decision date: 2025-03-04. Results received: No. Last updated: 2026-06-17.

Condition(s): Dialysis Heart failure
Product: FUROSEMIDE SODIUM

Primary endpoint: efficiency and safety measures, reduction in body fluid volume, weight, blood preasure, presence of oedema, bioimpedance values, ultrasound values (venous excess ultrasound score, VEXUS, and lung ultrasound), biochemical markers of congestion: CA125 and NT-proBNP
Endpoint(s): other measures of interest, Increased diuresis: 24-hour urine volume, 24-hour urine sodium

Source: https://euclinicaltrials.eu/ctis-public/view/2024-519356-87-00